EU clinical trial 2023-503686-26-02: PET/CT imaging with FAPI to predict response to anti-inflammatory therapy in patients with fibrotic interstitial lung disease: “The FIBRO-PET Study”
Sponsor: St Antonius Hospital (Hospital/Clinic/Other health care facility). Phase: Phase I and Phase II (Integrated)- Other. Countries: Netherlands (ongoing, recruiting).
Therapeutic area(s): Analytical, Diagnostic and Therapeutic Techniques and Equipment [E] - Diagnosis [E01]
Gender: Female, Male. Age: 18-64 years, 65+ years. Enrolment: 20.
Status: Ongoing, recruiting. Start date (EU): 2025-01-24. Decision date: 2024-09-20. Results received: No. Last updated: 2026-07-30.

Condition(s): Fibrotic Interstitial Lung Disease
Product: [18F]-AlF-FAPI-74

Primary endpoint: The difference in baseline wlTL-FAPI between participants classified as responders and non-responders at six months
Endpoint(s): The correlation between baseline wlTL-FAPI and the continuous absolute change in FVC% predicted from baseline to six months, The prognostic classification performance of baseline wlTL-FAPI, assessed using the area under the receiver operating characteristic curve and estimates of sensitivity, specificity, positive predictive value and negative predictive value, with 95% confidence intervals, Data-derived candidate wlTL-FAPI threshold(s) and their corresponding sensitivity, specificity, positive predictive value and negative predictive value, Between-group differences and associations for qualitative visual assessment, SUVmax, SUVmean, metabolic active volume and whole-lung metabolic active volume, The association between baseline wlTL-FAPI and the extent of fibrotic ILD and degree of reticulation on baseline HRCT, The association between baseline wlTL-FAPI and baseline serum inflammatory biomarkers

Source: https://euclinicaltrials.eu/ctis-public/view/2023-503686-26-02